EU clinical trial 2022-500448-39-00: Phase II study of [68Ga]Ga-ABY-025 PET for non-invasive quantification of HER2-status in solid tumors.
Protocol code: K2020-9716
Sponsor: Karolinska University Hospital (Hospital/Clinic/Other health care facility). Phase: Therapeutic exploratory (Phase II). Countries: Sweden (ongoing, recruitment ended).
Therapeutic area(s): Diseases [C] - Neoplasms [C04]
Gender: Female, Male. Age: 18-64 years, 65+ years. Enrolment: 72.
Status: Ongoing, recruitment ended. Start date (EU): 2022-11-20. Decision date: 2022-10-24. Results received: No. Last updated: 2025-05-09.

Condition(s): Gastro-esophageal cancer with HER2-expression (cohort 1). Breast cancer with low HER2-expression (‘HER2-low’) (cohort 2).

Primary endpoint: Percentage of HER2-expressing lesions (primary tumors and/or metastases) measured by [68Ga]Ga-ABY-025-uptake on PET/CT which are also positive regarding HER2-status defined by reference biopsy-based standard used in clinical routine in patients with GEAC.
Endpoint(s): 1. Optimal Standardized Uptake Values (SUVs) and Tumor-to-Background Ratio (TBR) cut-off values for separating HER2-expressing/or HER2-low from HER2-negative lesions by reference standard methods (combined and individual cohorts respectively)., 2. Percentage of [68Ga]Ga-ABY-025 uptake sites on whole-body PET/CT compared to all known cancer-related lesions (metastatic and primary, where applicable), determined on the routine radiological investigation with CT as an estimation of intra-individual heterogeneity of HER2-expression (cohort 1)., 3. Percentage of false-negative findings on [68Ga]Ga-ABY-025 whole-body PET/CT compared to results from IHC from at least one index lesion in patients with HER2-low mBC (cohort 2, pilot study), 4. Percentage of [68Ga]Ga-ABY-025 uptake in sites, not previously determined on the routine radiological investigation with CT, as a measure of cancer burden determined on the whole body [68Ga]Ga-ABY-025 PET/CT in primary tumors (where applicable) and different metastases (combined and individual cohorts respectively)., 5. Frequency of Adverse Events (AEs), Adverse Reactions (ARs), Serious Adverse Events (SAEs), and Suspected Unexpected Serious Adverse Reactions (SUSARs) (combined and individual cohorts respectively)., Exploratory endpoint 1. To examine the change in HER2 expression measured by [68Ga]Ga-ABY-025-uptake on PET/CT (SUVs and TBR) performed after 3 courses of chemotherapy/HER2 targeted drugs compared to pre-treatment values and in which proportion of the examined patients this occur (cohort 1)., Exploratory endpoint 2. Changes in SUVs in index lesions, as well as in the total HER2-expressing tumor volume at [68Ga]Ga-ABY-025 PET/CT (percentage) before and after treatment with systemic therapy including HER2 targeted drugs to evaluate treatment response (cohort 1)., Exploratory endpoint 3. Comparison of treatment response evaluation performed by [68Ga]Ga-ABY-025 PET/CT versus 18F-FDG PET/CT defined as percentage of complete and partial response, stable and progressive disease (percentage of concordant results, cohort 1)., Exploratory endpoint 4. The correlation between HER2 expression measured by a total HER2-expressing tumor volume at [68Ga]Ga-ABY-025 PET before treatment and progression-free survival (PFS), overall (or clinical) response rate to systemic therapy (ORR) at 12 months after inclusion (combined and individual cohorts respectively)., Exploratory endpoint 5. The presence and frequency of myocardial uptake of [68Ga]Ga-ABY-025 and relation to treatment-related cardiotoxicity by echocardiography (cohort 1)., Exploratory endpoint 6. The agreement between WB imaging and kinetic parameters in the determination of HER2-status (combined and individual cohorts respectively).

Source: https://euclinicaltrials.eu/ctis-public/view/2022-500448-39-00